EU clinical trial 2022-501027-25-01: TRIO: A prospective randomized Trial of non-inferiority comparing RItuximab versus Ocrelizumab in relapsing-remitting multiple sclerosis.
Protocol code: 35RC20_9812
Sponsor: CHU De Rennes (Hospital/Clinic/Other health care facility). Phase: Phase III and phase IV (Integrated). Countries: France (ongoing, recruitment ended).
Therapeutic area(s): Diseases [C] - Nervous System Diseases [C10]
Gender: Female, Male. Age: 18-64 years. Enrolment: 208.
Status: Ongoing, recruitment ended. Start date (EU): 2023-06-01. Decision date: 2022-12-02. Results received: No. Last updated: 2025-09-24.

Condition(s): Multiple Sclerosis, Multiple Sclerosis
Product: Ocrevus 300 mg concentrate for solution for infusion, Rituximab

Primary endpoint: % of patients without disease activity at 2 years. Disease activity is defined as: - At least one relapse between baseline and M24 - OR MRI activity defined as Gd enhancing lesions at M6 or as the appearance of at least one new T2 lesion between M6 and M24
Endpoint(s): Clinical criteria - Relapses: annualized relapse rate, mean time of onset of the first relapse, % of patients without relapse at M24, - Disability progression: % of patients without disability progression at M24 Disability progression will be defined as an increase of 1.5 pt if baseline EDSS=0, 1pt EDSS (if baseline 1 ≤ EDSS<6), or an increase of 0.5pt if baseline EDSS is ≥ 6; confirmed at 6 months. MRI Criteria - Mean number of Gd enhancing lesions at M6; - % of patients with at least one Gd, MRI Criteria - Mean number of Gd enhancing lesions at M6; - % of patients with at least one Gd enhancing lesion(s) at M6; - Mean number of new or enlarging brain T2 lesion from M6 to M24; % of patients with one or more new or enlarging brain T2 lesions from M6 to M24;, Quality of life - Change in the EQ5D-5L score from baseline to every six month of follow up until M24 - Change in the MusiQOL score from baseline to M12 and baseline to M24., Patients experience - Change in the Musicare score from baseline to M12 and baseline to M24., Medico-economic Incremental Cost-Effectiveness Ratio (ICER) defined as the cost for QALY gained in “ocrelizumab group” versus “rituximab group” at 24 months., Safety - The number of each adverse event and number of severe adverse events will be compared between the two groups.

Source: https://euclinicaltrials.eu/ctis-public/view/2022-501027-25-01